EU clinical trial 2024-513515-27-00: PRODIGE 55-SOCRATE : A randomized phase II study to evaluate second-line ramucirumab alone or with paclitaxel in older patients with advanced gastric cancer
Sponsor: Fondation Franc.Cancerologie Digestive (Hospital/Clinic/Other health care facility). Phase: Therapeutic exploratory (Phase II). Countries: France (ended).
Therapeutic area(s): Diseases [C] - Digestive System Diseases [C06]; Diseases [C] - Neoplasms [C04]
Gender: Female, Male. Age: 65+ years. Enrolment: 112.
Status: Ended. Start date (EU): 2024-07-10. End date (EU): 2025-09-26. Decision date: 2024-07-10. Results received: No. Last updated: 2025-01-20.

Condition(s): stomach cancer stage IV with metastases
Product: Cyramza 10 mg/ml concentrate for solution for infusion, PACLITAXEL AHCL 6 mg/ml, solution à diluer pour perfusion

Primary endpoint: Six months survival rate and quality of life at 4 months
Endpoint(s): description of observed toxicities graded according to NCI-CTC V4 and description of SAEs, dose intensity will be assessed by the ratio (expressed as a %): actual dose(DR)/theoretical dose(DT) for each chemotherapy product (Ramucirumab or Paclitaxel), The time to deterioration in autonomy was defined as the time between the date of randomisation and the date on which the IADL score decreased by at least 1 point compared with the score calculated at inclusion. Patients who were alive or who died without deterioration in autonomy were censored at the date of the last IADL assessment or at the date of death., Time to deterioration of quality of life scores is defined as the time between the date of randomisation and the date of deterioration of the EORTC QLQC30 and ELD 14 scores by 10 points relative to the score at inclusion. Patients alive or who died without deterioration will be censored at the date of last QoL assessment or at the date of death., Overall survival is defined as the time from the date of randomisation to the date of death from any cause. Patients lost to follow-up or alive at the time of analysis will be censored at the date of last news., Time to treatment failure is defined as the time between the date of randomisation and the date of treatment failure (progression and/or treatment discontinuation or death (whatever the cause). Patients without treatment discontinuation will be censored at the date of last treatment administration., Progression-free survival is defined as the time between the date of randomisation and the date of first clinical and/or radiological progression or death (from any cause). Patients alive without progression will be censored at the date of last news., Evaluation of geriatric parameters (every 2 months)

Source: https://euclinicaltrials.eu/ctis-public/view/2024-513515-27-00